EU clinical trial 2025-520761-44-00: Antibiotic therapy vs. placebo in the treatment of acute uncomplicated appendicitis: a prospective randomized double-blind placebo-controlled trial - APPAC III
Sponsor: Turku University Hospital (Hospital/Clinic/Other health care facility). Phase: Therapeutic use (Phase IV). Countries: Finland (authorised, recruitment pending).
Therapeutic area(s): Diseases [C] - Digestive System Diseases [C06]
Gender: Female, Male. Age: 18-64 years. Enrolment: 72.
Status: Authorised, recruitment pending. Decision date: 2025-01-29. Results received: No. Last updated: 2025-01-29.

Condition(s): Uncomplicated acute appendicitis
Product: ERTAPENEM, METRONIDAZOLE, LEVOFLOXACIN, The placebo used in the study was manufactured by the hospital pharmacy. Both the investigational drugs and the placebo were packaged in identical containers by the hospital pharmacy to ensure blinding.

Primary endpoint: The primary endpoint is the success of the randomized treatment (treatment efficacy). The treatment success is defined as the resolution of acute appendicitis with study treatment resulting in discharge from the hospital without the need for surgical intervention and treatment efficacy evaluated at ten days after initiation of the randomized treatment.
Endpoint(s): Secondary endpoints include post-intervention complications (Clavien-Dindo classification), late recurrence of acute appendicitis after study treatment defined as clear clinical suspicion of acute appendicitis evaluated at follow-up of one, three, five and ten years, duration of hospital stay, VAS scores, quality of life (QOL, 15D), sick leave and treatment costs.

Source: https://euclinicaltrials.eu/ctis-public/view/2025-520761-44-00